EU clinical trial 2023-503550-13-00: A Study of DR-01 in Adult Subjects With Large Granular Lymphocytic Leukemia or Cytotoxic Lymphomas
Protocol code: DR-01-ONC-001
Sponsor: Dren Bio 01 Inc. (Pharmaceutical company). Phase: Phase I and Phase II (Integrated)- First administration to humans. Countries: Spain (ongoing, recruiting), France (ongoing, recruiting), Germany (ongoing, recruiting), Italy (ongoing, recruiting).
Therapeutic area(s): Diseases [C] - Hemic and Lymphatic Diseases [C15]
Gender: Female, Male. Age: 18-64 years, 65+ years. Enrolment: 51.
Status: Ongoing, recruiting. Start date (EU): 2024-08-08. Decision date: 2023-07-03. Results received: No. Last updated: 2026-07-29.
Decision dates by country: DE: 2024-02-02, ES: 2023-07-03, FR: 2023-07-07, IT: 2024-06-05

Condition(s): Large Granular Lymphocytic Leukemia or Cytotoxic Lymphomas

Source: https://euclinicaltrials.eu/ctis-public/view/2023-503550-13-00